EU clinical trial 2024-511124-14-00: An open-label, non-randomised safety and tolerability Proof of Concept Trial to examine multiple dosing addition of glycocholate (GC) and butyrate (B) to increase Ca absorption in healthy female participants that have undergone Roux-en-Y gastric bypass (BAFA)
Sponsor: Vaestra Goetalandsregionen (Hospital/Clinic/Other health care facility). Phase: Phase I and Phase II (Integrated)- First administration to humans. Countries: Sweden (ongoing, recruiting).
Therapeutic area(s): Diseases [C] - Musculoskeletal Diseases [C05]; Diseases [C] - Digestive System Diseases [C06]
Gender: Female, Male. Age: 18-64 years. Enrolment: 12.
Status: Ongoing, recruiting. Start date (EU): 2024-12-10. Decision date: 2024-05-28. Results received: No. Last updated: 2025-08-27.

Condition(s): Postoperative obesity
Product: BAFA - Butyrate 90 mg and Glycocholate 480 mg Oral solution

Primary endpoint: Safety and tolerability
Endpoint(s): PTH concentrations, Ca urinary excretion during 24 h, Bone resorption markers P1NP, CTX and BALP

Source: https://euclinicaltrials.eu/ctis-public/view/2024-511124-14-00